EU clinical trial 2024-513828-42-00: CERICA - CERebrolysin In CADASIL - A randomized, double-blind, single-centre, two-period cross-over, placebo-controlled trial on safety and efficacy in patients with genetically proven CADASIL
Sponsor: Ever Neuro Pharma GmbH (Pharmaceutical company). Phase: Therapeutic exploratory (Phase II). Countries: Czechia (ongoing, recruitment ended).
Therapeutic area(s): Diseases [C] - Nervous System Diseases [C10]
Gender: Female, Male. Age: 18-64 years, 65+ years. Enrolment: 30.
Status: Ongoing, recruitment ended. Start date (EU): 2023-11-29. Decision date: 2024-09-19. Results received: No. Last updated: 2024-09-19.

Condition(s): Cerebral Autosomal Dominant Arteriopathy with subcortical Infarcts and Leukoencephalopathy (CADASIL)
Product: Sodium chloride Fresenius Kabi 0,9% infuzní roztok, Cerebrolysin 215,2mg/ml Injekční roztok

Primary endpoint: The primary multidimensional outcome ensemble comprises 10 single analysis variables of three dimensions (cognition, mood, imaging characteristics) assessed during and at the end of treatment phases I and II (at months 6, 12, 21, and 27). Month 12 (end of phase I) and Month 27 (end of phase II) are the primary endpoints of the formal cross-over analysis.

Source: https://euclinicaltrials.eu/ctis-public/view/2024-513828-42-00